EU clinical trial 2023-505590-33-06: Individualized everolimus therapy in metastatic breast cancer
Protocol code: PANONC-2
Sponsor: Orszagos Onkologiai Intezet (Hospital/Clinic/Other health care facility). Phase: Therapeutic exploratory (Phase II). Countries: Hungary (authorised, recruitment pending).
Therapeutic area(s): Diseases [C] - Neoplasms [C04]
Gender: Female, Male. Age: 18-64 years, 65+ years. Enrolment: 64.
Status: Authorised, recruitment pending. Decision date: 2025-03-19. Results received: No. Last updated: 2025-03-19.

Condition(s): metastatic breast cancer
Product: Verimmus 5 mg tabletta, Verimmus 10 mg tabletta, Everolimus Onkogen 5 mg tabletta, Everolimus Onkogen 10 mg tabletta, EXEMESTANE

Primary endpoint: Change in the quality of life in the two study arms, examined with the FACT-B quality of life test. Hypothesis: the difference between the averages of the quality of life measured on the basis of the FACT-B questionnaire (FACT-B total score) between the two arms (FACT-BA-arm-FACT-BB-arm) improves by 20% in the divided-dose arm in favor of the sinle-dose arm at the end of the four-month treatment.
Endpoint(s): Examination of quality of life in the two arms: does the difference in the average of the quality of life values measured with each test between the two arms change by at least 10 points by the end of the four-month treatment, measured with the following specific tools o EORTC C30 global health value o EORTC C30 physical functionality o EORTC C30 fatigue o EORTC BR23 systemic treatment side effect, The ratio of the response rate in the two arms. Clinical response is defined as complete or partial remission according to RECIST v1.1. Patients who do not develop such a response, or for whom efficacy cannot be assessed for any reason, are considered non-responders., Safety study: occurrence and severity of side effects in the two arms evaluated according to NCI CTCAE v5.0. All patients who received at least one dose of everolimus are included in the analysis., Evolution of pharmacokinetic values (Ctrough and Cmax) in the two arms, Rate of successful dose increase based on pharmacological data: determining whether it is possible to increase the dose and maintain the increased dose based on the pharmacological parameters. If a dose increase is justified based on the serum levels (Ctrough and Cmax) according to the protocol, will the patient tolerate the increased dose (12.5 mg/day or 15 mg/day) until the end of the study. Hypothesis: 20% of patients have the possibility of a successful dose increase., Dose intensity: evaluation of the relative dose intensity (taken dose/planned dose) in the two arms. All patients who received at least one dose of everolimus are included in the analysis.

Source: https://euclinicaltrials.eu/ctis-public/view/2023-505590-33-06